EU clinical trial 2023-506700-12-00: A Study Evaluating the Safety, Pharmacokinetics, and Activity of GDC-9545 Alone or in Combination with Palbociclib and/or LHRH Agonist in Patients with Locally Advanced or Metastatic Estrogen Receptor−Positive Breast Cancer
Protocol code: GO39932
Sponsor: Genentech Inc. (Pharmaceutical company). Phase: Human Pharmacology (Phase I)- Other. Countries: Spain (ongoing, recruitment ended).
Therapeutic area(s): Diseases [C] - Neoplasms [C04]
Gender: Female. Age: 18-64 years, 65+ years. Enrolment: 45.
Status: Ongoing, recruitment ended. Start date (EU): 2018-06-18. Decision date: 2024-02-23. Results received: No. Last updated: 2026-04-21.

Condition(s): Locally Advanced or Metastatic Estrogen Receptor−Positive Breast Cancer

Source: https://euclinicaltrials.eu/ctis-public/view/2023-506700-12-00